EU clinical trial 2023-505070-15-00: Phase 1/2 Open-label Study of BMS-986466 in Combination with Adagrasib with or without Cetuximab in Participants with KRAS G12C-mutant Advanced Solid Tumors
Protocol code: CA126-0015
Sponsor: Bristol-Myers Squibb Services Unlimited Company (Pharmaceutical company). Phase: Phase I and Phase II (Integrated)- Other. Countries: Spain (ended), Finland (ended), France (ended), Italy (ended), Belgium (ended).
Therapeutic area(s): Diseases [C] - Neoplasms [C04]
Gender: Female, Male. Age: 18-64 years, 65+ years. Enrolment: 62.
Status: Ended. End date (EU): 2024-03-15. End date: 2024-05-13. Decision date: 2024-01-23. Results received: Yes. Last updated: 2024-03-15.
Decision dates by country: BE: 2024-03-15, IT: 2024-01-25, FI: 2024-01-23, FR: 2024-01-29, ES: 2024-01-29

Condition(s): Oncology, NSCLC and CRC
Product: BBP-398, CETUXIMAB, ADAGRASIB

Primary endpoint: Incidence of Dose Limiting Toxicities, Adverse Events, Serious Adverse Events, Adverse Events leading to discontinuation, and deaths., Overall Response Rate (ORR) per RECIST v1.1 by Blinded Independent Central Review (BICR).
Endpoint(s): Summary measures of BMS-986466 PK parameters in plasma including Maximum concentration (Cmax), Time to maximum concentration (Tmax), and Area Under the Curve (AUC(0-T)) from concentration-time data., Progression Free Survival (PFS), Disease Control Rate (DCR), Duration of Response (DOR), and Time To Response (TTR) per RECIST v1.1 by BICR., Incidence of Dose Limiting Toxicities, Adverse Events, Serious Adverse Events, Adverse Events leading to discontinuation, and deaths., Summery measures of target engagement (ability of a drug to bind to a specific molecule)

Source: https://euclinicaltrials.eu/ctis-public/view/2023-505070-15-00